EU clinical trial 2024-515116-42-00: The effects of intravenous iron on mobility in elderly patients following hip fracture surgery: a multicentre, parallel group, randomised, controlled trial
Sponsor: Region Hovedstaden (Hospital/Clinic/Other health care facility). Phase: Therapeutic use (Phase IV). Countries: Denmark (ongoing, recruiting).
Therapeutic area(s): Diseases [C] - Musculoskeletal Diseases [C05]
Gender: Female, Male. Age: 65+ years. Enrolment: 210.
Status: Ongoing, recruiting. Start date (EU): 2025-06-02. Decision date: 2025-02-09. Results received: No. Last updated: 2025-02-09.

Condition(s): Hip fracture
Product: Ferric derisomaltose Pharmacosmos 100 mg/ml solution for injection/infusion, Natriumklorid Fresenius Kabi 9 mg/ml

Primary endpoint: Participants will report their pre-fracture NMS at baseline. NMS will be assessed by phone at week 4 post-intervention and in-person at weeks 6 and 12. Mobility recovery from pre-fracture will be analyzed using repeated measures mixed linear models, with the primary endpoint being NMS after 6 weeks, estimated by least squares means difference
Endpoint(s): 1. Haemoglobin Blood test will be obtained, and haemoglobin analysed at baseline and following the 6- and 12-week patient visit., 2. Red blood cell transfusion requirement: This will be measured by the proportion of patients who receive at least one red blood cell unit and the amounts of units per patient on postoperative day (POD) 7 and POD 30 attained from electronic patient records., 3. Fatigue will be measured with ‘Verbal rating scale – Fatigue’ from 0, 4 and at 6 and 12 weeks after intervention, 4. Quality of life: This will be measured by dedicated staff using the questionnaire EQ-5D-5L and EQ VAS 0-100, on inclusion as a retrograde baseline the weeks prior to admission and at 6 and 12 weeks after intervention., 5. Fear of falls: Short Falls efficacy scale International (Short-FES-I) for assessment of concern for falling during different activities measured at baseline and at 6 and 12 weeks after intervention, 6. 30 second Sit-to-Stand-Test (STS) The test uses a chair placed against a wall, with the participant seated in the middle and arms crossed at the chest. Participants are encouraged to stand and fully sit as many times as possible within 30 seconds, with correct form monitored by the tester. Measured at baseline, 6 and 12 weeks. Measured at baseline, 6 and 12 weeks. Measured at baseline, 6 and 12 weeks. Measured at baseline and at 6 and 12 weeks., 6. Activity of daily living: Barthel Index 20 Barthel measured at baseline and at 6 and 12 weeks after intervention., 7. Pain: Hip fracture-related pain during activity will be evaluated with the verbal rating scale, 0-4 points, at baseline and at 6 and 12 weeks after intervention., 8. Days alive and at home up to 30 days, assessed at 6 week follow up, 9. Serious adverse event: SAE defined following the ICH – GCP guidelines. Will be assessed at the 6 weeks follow up., 10. Mortality: 90 days following enrolment it is obtained if patients are alive from patient electronic medical records and from this survival, 30 and 90 mortality is calculated

Source: https://euclinicaltrials.eu/ctis-public/view/2024-515116-42-00